EU clinical trial 2022-502738-18-00: MASTER PROTOCOL: A Phase 2, Open-label, Multi-arm Study of Tislelizumab in Combination With Investigational Agents With or Without Chemotherapy in Patients With Previously Untreated, Locally Advanced, Unresectable, or Metastatic Non-Small Cell Lung Cancer.
Protocol code: BGB-LC-201
Sponsor: BeOne Medicines AG (Pharmaceutical company). Phase: Therapeutic exploratory (Phase II). Countries: France (ended), Italy (ended), Spain (ended), Romania (ongoing, recruitment ended).
Therapeutic area(s): Diseases [C] - Neoplasms [C04]
Gender: Female, Male. Age: 18-64 years, 65+ years. Enrolment: 22.
Start date (EU): 2023-09-15. Decision date: 2023-08-22. Results received: No. Last updated: 2026-07-06.
Decision dates by country: FR: 2023-08-23, IT: 2023-08-23, ES: 2023-08-22, RO: 2023-08-23

Condition(s): Metastatic Non-small Cell Lung Cancer, Non-small Cell Lung Cancer
Product: Cisplatin 1 mg/ml Concentrate for Solution for Infusion, ALIMTA 500 mg powder for concentrate for solution for infusion, Apealea 60 mg powder for solution for infusion., Abraxane 5 mg/ml powder for dispersion for infusion., Carboplatin 10 mg/ml Concentrate for Solution for Infusion, Tislelizumab, LBL-007, BGB-15025, BGB-A445

Primary endpoint: Confirmed overall response rate (ORR) as assessed by the investigators per Response Evaluation Criteria in Solid Tumors (RECIST) Version (v)1.1
Endpoint(s): Progression-free survival (PFS), duration of response (DOR), clinical benefit rate (CBR), and disease control rate (DCR) as assessed by the investigator per RECIST v1.1., The incidence and severity of adverse events according to National Cancer Institute Common Terminology Criteria for Adverse Events NCI-CTCAE v5.0 in reference arms and experimental arms., Plasma or serum concentrations of tislelizumab and investigational agents at specified timepoints., Immunogenic responses to tislelizumab and investigational protein therapeutics, evaluated through the detection of antidrug antibodies (ADA).

Source: https://euclinicaltrials.eu/ctis-public/view/2022-502738-18-00